EU clinical trial 2024-511553-22-00: A Phase 3, Multicenter, Open-Label Extension Study of Oral Ozanimod for Moderately to Severely Active Crohn's Disease
Protocol code: RPC01-3204
Sponsor: Celgene International II SARL (Pharmaceutical company). Phase: Therapeutic confirmatory (Phase III). Countries: Germany (ended), Hungary (ended), Slovakia (ended), Italy (ended), Netherlands (ended), Ireland (ended), Romania (ended), Portugal (ended), Czechia (ended), Croatia (ended), Poland (ended), Spain (ended), Latvia (ended), Bulgaria (ended), France (ended).
Therapeutic area(s): Diseases [C] - Digestive System Diseases [C06]
Gender: Female, Male. Age: 18-64 years, 65+ years. Enrolment: 462.
Status: Ended. Start date (EU): 2018-10-05. End date (EU): 2024-10-31. End date: 2024-11-01. Decision date: 2024-04-30. Results received: Yes. Last updated: 2024-11-11.
Decision dates by country: NL: 2024-06-04, ES: 2024-06-04, PL: 2024-06-04, HU: 2024-05-02, DE: 2024-05-06, PT: 2024-06-04, BG: 2024-06-04, IT: 2024-06-04, LV: 2024-06-04, FR: 2024-06-04, RO: 2024-06-04, IE: 2024-06-04, SK: 2024-06-04, HR: 2024-06-04, CZ: 2024-06-04

Condition(s): Moderately to Severely Active Crohn's Disease
Product: Ozanimod, Ozanimod

Primary endpoint: Proportion of subjects with a CDAI score of < 150, Proportion of subjects with a SES-CD decrease from baseline of ≥ 50%, Proportion of subjects with average daily abdominal pain score ≤ 1 point, and average daily stool frequency ≤ 3 points with abdominal pain and stool frequency no worse than baseline, Proportion of subjects with CDAI reduction from baseline of ≥ 100 points or CDAI score of < 150, Proportion of subjects with absence of ulcers ≥ 0.5 cm with no segment with any ulcerated surface ≥ 10%, Proportion of subjects with CDAI reduction from baseline of ≥ 70 points, Change from baseline in CDAI, Proportion of subjects with CDAI reduction from baseline of ≥ 100 points or CDAI score of < 150 and SES-CD decrease from baseline of ≥ 50%, Proportion of subjects with CDAI score of < 150 and SES-CD ≤ 4 points and a SES CD decrease ≥ 2 points, Proportion of subjects with average daily abdominal pain score ≤ 1 point and average daily stool frequency ≤ 3 points and a stool frequency no worse than baseline and SES-CD ≤ 4 points and a SES-CD decrease ≥ 2 points, Proportion of subjects with SES-CD ≤ 4 points and a SES-CD decrease ≥ 2 points, Proportion of subjects with a CDAI score < 150 in subjects off corticosteroids, Proportion of subjects with a Crohn's Disease Endoscopic Index of Severity (CDEIS) decrease from baseline of ≥ 50%, Proportion of subjects with average daily abdominal pain score ≤ 1 point, average daily stool frequency ≤ 3 points with abdominal pain and stool frequency no worse than baseline, and SES-CD decrease from baseline ≥ 50%, Efficacy in subjects (clinical response, clinical remission, and endoscopic improvement) as a function of baseline and change- from baseline in biomarkers (eg, C-reactive protein, fecal calprotectin, high-density lipoprotein, IgA, IL-7), To assess impact of SARS-CoV-2 serologic status on subjects receiving ozanimod and CD, Exploratory measurements of SARS-CoV-2 serology (anti-SARS-CoV-2 total or IgG), from serum samples collected every 48 weeks.

Source: https://euclinicaltrials.eu/ctis-public/view/2024-511553-22-00